EU clinical trial 2023-510522-32-00: MucPreDex: Radiation-induced MUCositis PREvention using DEXpanthenol mouth rinse
Protocol code: STR-202301
Sponsor: Rheinische Friedrich-Wilhelms-Universitaet Bonn (Educational Institution). Phase: Therapeutic confirmatory (Phase III). Countries: Germany (ongoing, recruiting).
Therapeutic area(s): Diseases [C] - Pathological Conditions, Signs and Symptoms [C23]
Gender: Female, Male. Age: 18-64 years, 65+ years. Enrolment: 126.
Status: Ongoing, recruiting. Start date (EU): 2025-08-29. Decision date: 2024-10-30. Results received: No. Last updated: 2026-07-09.

Condition(s): radiation-induced oral mucositis
Product: Aqua conservata, Bepanthen® LÖSUNG 50 mg/ml Lösung

Primary endpoint: Grading of oral mucositis according to NCI CTCAE v5.0
Endpoint(s): Grading of oral mucositis according to NCI CTCAE v5.0, Number of cases with oral mucositis, Gustometry score (including the taste qualities, sour, bitter, and salty), the results of the rhinomanometry examination of nasal pressure (resistance coefficient between the nostril and the nasopharynx), the results of the rhinomanometry examination of airflow during breathing per side, assessed by the trial personnel: Grading of Fatigue, oral pain, dysphagia, and weight loss according to NCI CTCAE v5.0, from the subject’s perspective: EORTC QLQ – C30 questionnaire: item scales (Dyspnoea, Insomnia, Appetite loss, Constipation, Diarrhoea, Financial difficulties), functional scales (physical functioning, role functioning, emotional functioning, cognitive functioning, social functioning), and symptom scales (Fatigue, Nausea and vomiting, pain), from the subject’s perspective: EORTC QLQ–H&N43 questionnaire: item scales (Social contact, Swelling in the neck, Coughing, Neurological problems, Problems opening mouth, Weight loss, Problems with wound healing) and multi-item scales (Social eating, Body image, Pain in the mouth, Problems with senses, Fear of progression/Anxiety, Skin problems, Speech, Swallowing, Problems with teeth, Dry mouth and sticky saliva, Problems with shoulder), a) radiotherapy: Proportion of patients, who prematurely terminate their radiation therapy or have delays in therapy fractions due to adverse effects associated with radiotherapy, a) radiotherapy: Percentage compliance of subjects with planned radiotherapy, b) IMP treatment: Number of unopened IMP bottles returned and opened IMP bottles returned with remaining content, Frequency and intensity of adverse reactions of the IMP, Frequency and intensity of collateral symptoms related to radiotherapy (expected radiation adverse events per NCI CTCAE v5.0)

Source: https://euclinicaltrials.eu/ctis-public/view/2023-510522-32-00